EU clinical trial 2025-522831-33-00: A Phase 2, Multicenter, Randomized, Double-Blind, Placebo-Controlled Trial to Assess Efficacy and Safety of Zasocitinib in Moderate to Severe Hidradenitis Suppurativa
Protocol code: TAK-279-HS-2001
Sponsor: Takeda Development Center Americas Inc. (Pharmaceutical company). Phase: Therapeutic exploratory (Phase II). Countries: France (authorised, recruitment pending), Poland (authorised, recruitment pending), Netherlands (authorised, recruitment pending), Germany (authorised, recruitment pending).
Therapeutic area(s): Diseases [C] - Skin and Connective Tissue Diseases [C17]
Gender: Female, Male. Age: 18-64 years, 65+ years. Enrolment: 36.
Status: Authorised, recruitment pending. Decision date: 2026-03-06. Results received: No. Last updated: 2026-03-23.
Decision dates by country: FR: 2026-03-06, DE: 2026-03-19, NL: 2026-03-23, PL: 2026-03-23

Condition(s): Hidradenitis Suppurativa
Product: ZASOCITINIB, Matching Placebo for TAK-279

Primary endpoint: Hidradenitis Suppurativa Clinical Response 75 (HiSCR75) at Week 16, assessed as proportion of participants who achieve HiSCR75 at Week 16. Hidradenitis Suppurativa Clinical Response 75 is defined as at least a 75% reduction in the total abscess and inflammatory nodule (AN) count with no increase in abscess or draining tunnel count relative to baseline.
Endpoint(s): HiSCR50 at Week 16, assessed as proportion of participants who achieve HiSCR50 at Week 16., Incidence of treatment emergent adverse events (TEAEs) throughout the trial.

Source: https://euclinicaltrials.eu/ctis-public/view/2025-522831-33-00